EU clinical trial 2025-521205-41-00: A Randomized, placebo-controlled, double-blinded Phase 2 Trial of Dapagliflozin for Preventing Treatment-associated Cardiotoxicity in Lymphoma
Protocol code: DACALY
Sponsor: Aalborg University Hospital (Hospital/Clinic/Other health care facility). Phase: Therapeutic exploratory (Phase II). Countries: Denmark (ongoing, recruiting).
Therapeutic area(s): Diseases [C] - Neoplasms [C04]
Gender: Female, Male. Age: 18-64 years, 65+ years. Enrolment: 74.
Status: Ongoing, recruiting. Start date (EU): 2026-03-12. Decision date: 2025-09-14. Results received: No. Last updated: 2026-05-20.

Condition(s): Diffuse large B-cell lymphoma NOS, follicular lymphoma Grade 3b, anaplastic large T-cell lymphoma (ALK positive), follicular lymphoma grade 1-3a, and T-cell lymphomas.
Product: DAPAGLIFLOZIN, PLACEBO

Primary endpoint: The primary endpoint is the change in global longitudinal strain between baseline and first month after end of treatment, where we define a ≥10% reduction as significant and indicative of cardiotoxicity in agreement with previous published studies.
Endpoint(s): Diastolic parameter changes including the mitral valve filling pattern assessed by Doppler velocity measurements, the E/A ratio representing the early wave velocity (E) to the late velocity after atrial contraction (A), the deceleration time of the E wave, the early and late velocities of the mitral annulus measured by tissue Doppler (e′ and a′), isovolumetric relaxation time (IVRT), the left atrial volume, and the derived E/ e′., Change in right ventricle related parameters including TAPSE and TRmax, LVEF change assessed using WMI and Simpson biplane in addition to change in cardiac output assessed using VTI., Change in serum values of troponin T or I and N-Terminal pro-B-type natriuretic peptide (NT-proBNP) or proBNP., ECG findings and changes in relation to echocardiographic measurements and rate of heart failure, Rate of heart failure in the placebo and SGLT2 inhibitor arm, Coronary artery calcium score in pre-planned, interim and end of treatment computer tomography (CT) scans in relation to ischemic heart disease and heart failure, Cardiopulmonary symptoms during follow-up using New York Heart Association (NYHA)., Tolerability of SGLT2 inhibitors administered in combination with R-CHOP, assessed using descriptive summaries of CTCAE reportings and dose reductions/interruptions/discontinuations

Source: https://euclinicaltrials.eu/ctis-public/view/2025-521205-41-00